EU clinical trial 2025-524587-37-00: An Open-Label, Single-Arm Phase 1 Trial to Evaluate The Safety, Tolerability and Efficacy of Vididencel in Chronic Phase Chronic Myeloid Leukemia Patients with Measurable Residual Disease Unable to Meet Requirements of Treatment Free Remission under Tyrosine Kinase Inhibitor Treatment
Protocol code: VITAL-CML
Sponsor: Mendus B.V. (Pharmaceutical company). Phase: Human Pharmacology (Phase I)- Other. Countries: Norway (ongoing, recruiting).
Therapeutic area(s): Diseases [C] - Neoplasms [C04]
Gender: Female, Male. Age: 18-64 years, 65+ years. Enrolment: 24.
Status: Ongoing, recruiting. Start date (EU): 2026-03-31. Decision date: 2026-03-31. Results received: No. Last updated: 2026-03-31.

Condition(s): Chronic Phase Chronic Myeloid Leukemia

Source: https://euclinicaltrials.eu/ctis-public/view/2025-524587-37-00